EU clinical trial 2023-504511-32-00: ATLANTIS Protamine - Antagonization of heparin with protamine sulfate to reduce all neurologic ischemic and hemorrhagic events after transcatheter aortic valve implantation for aortic stenosis: the ATLANTIS Protamine study.
Protocol code: APHP211046
Sponsor: Assistance Publique Hopitaux De Paris (Hospital/Clinic/Other health care facility). Phase: Therapeutic confirmatory (Phase III). Countries: France (ongoing, recruiting).
Therapeutic area(s): Diseases [C] - Cardiovascular Diseases [C14]
Gender: Female, Male. Age: 18-64 years, 65+ years. Enrolment: 940.
Status: Ongoing, recruiting. Start date (EU): 2025-05-24. Decision date: 2023-12-15. Results received: No. Last updated: 2026-06-12.

Condition(s): Any patients ≥18 years old, eligible for transfemoral TAVI with coverage for medical insurance
Product: PROTAMINE CHOAY 1000 U.A.H./ml, solution injectable

Primary endpoint: The primary endpoint is defined as the first occurrence, from procedure to hospital discharge, of any event of the composite of all-cause mortality, type 2, 3 or 4 bleeding, major or minor vascular complications, stroke or TIA, myocardial infarction or any red-blood transfusion. The primary endpoint will be blindly determined by a clinical event committee according to the valve Academic Research Consortium-3 (VARC-3 classifications)
Endpoint(s): Assessment of length of in-hospital stay in days post TAVI procedure, Assessment of the occurrence from procedure to hospital discharge of: Type 2, 3 or 4 bleeding according to the VARC 3 criteria or any red blood cell transfusion of minor or vascular complications. Type 2, 3 or 4 bleedings or red blood cell transfusion. Any red blood cell transfusion Type 2, 3 or 4 bleedings, Assessment of an interaction in the impact of systematic antagonization according to the use or not of an echo-guided femoral puncture and/or arterial radial access. These subgroups are defined at the time of randomization by stratification., Assessment of the occurrence from procedure to hospital discharge of: Death or type 2, 3 or 4 bleedings Any kidney injury, stage 2 to 4 according to the KDIGO definition Death, type 2, 3 or 4 bleedings or stroke De a th, VARC 3 type 2-3-4 bleeding or Any red blood cell transfusion, MI or stroke Or TIA Any myocardial infarction, stroke or TIA Type 3 or 4 bleeding Type 2 bleeding Minor vascular complications Access site and access related vascular injury according to VARC-3 criteria

Source: https://euclinicaltrials.eu/ctis-public/view/2023-504511-32-00